EU clinical trial 2024-517752-35-00: A phase I study of the mesothelin x cd47 antibody NI-1801, as single agent and in combination with anti-pd-1 antibody, or with paclitaxel alone in solid cancers or with anti-pd-1 and paclitaxel +/- bevacizumab in proc
Protocol code: LCB-1801-001
Sponsor: NovImmune S.A. (Pharmaceutical company). Phase: Human Pharmacology (Phase I)- First administration to humans. Countries: France (ongoing, recruiting), Italy (ongoing, recruiting), Spain (ongoing, recruiting).
Therapeutic area(s): Diseases [C] - Neoplasms [C04]
Gender: Female, Male. Age: 18-64 years, 65+ years. Enrolment: 106.
Status: Ongoing, recruiting. Start date (EU): 2022-04-04. Decision date: 2024-11-05. Results received: No. Last updated: 2026-06-17.
Decision dates by country: IT: 2024-11-11, ES: 2025-05-23, FR: 2024-11-05

Condition(s): Advanced, metastatic, or recurrent solid mesothelin-expressing malignancies

Source: https://euclinicaltrials.eu/ctis-public/view/2024-517752-35-00